EU clinical trial 2024-518343-38-00: An Open-Label Extension Study to Assess the Safety and Efficacy of Vutrisiran in Patients with Transthyretin Amyloidosis with Cardiomyopathy (ATTR Amyloidosis with Cardiomyopathy)
Protocol code: ALN-TTRSC02-007
Sponsor: Alnylam Pharmaceuticals Inc. (Pharmaceutical company). Phase: Therapeutic confirmatory (Phase III). Countries: Spain (ongoing, recruitment ended), Denmark (ongoing, recruitment ended), Netherlands (ongoing, recruitment ended), Belgium (ongoing, recruitment ended), Norway (ongoing, recruitment ended), Portugal (ongoing, recruitment ended), Czechia (ongoing, recruitment ended), Austria (ongoing, recruitment ended), Italy (ongoing, recruitment ended), France (ongoing, recruitment ended), Sweden (ongoing, recruitment ended).
Therapeutic area(s): Diseases [C] - Cardiovascular Diseases [C14]
Gender: Female, Male. Age: 18-64 years, 65+ years. Enrolment: 208.
Status: Ongoing, recruitment ended. Start date (EU): 2025-02-12. Decision date: 2025-01-28. Results received: No. Last updated: 2026-07-22.
Decision dates by country: AT: 2025-03-31, BE: 2025-01-29, CZ: 2025-01-31, DK: 2025-01-29, IT: 2025-01-31, NL: 2025-02-03, NO: 2025-01-28, PT: 2025-01-28, ES: 2025-01-29, SE: 2025-03-31, FR: 2025-04-03

Condition(s): Transthyretin Amyloidosis with Cardiomyopathy (ATTR Amyloidosis with Cardiomyopathy)
Product: Amvuttra 25 mg solution for injection in pre-filled syringe

Primary endpoint: Frequency of adverse events
Endpoint(s): Change from baseline in KCCQ-OS score, Change from baseline in NYHA class, Change from baseline in cardiac biomarkers (NT-proBNP and troponin I), All-cause mortality and recurrent CV events (CV hospitalizations and urgent HF visits), Change from baseline in serum TTR level

Source: https://euclinicaltrials.eu/ctis-public/view/2024-518343-38-00